EU clinical trial 2024-515408-37-00: MRI with hyperpolarized pyruvate in gliblastoma - a phase II study
Sponsor: Aarhus Universitet (Educational Institution). Phase: Therapeutic exploratory (Phase II). Countries: Denmark (ongoing, recruiting).
Therapeutic area(s): Analytical, Diagnostic and Therapeutic Techniques and Equipment [E] - Diagnosis [E01]; Diseases [C] - Neoplasms [C04]
Gender: Female, Male. Age: 18-64 years, 65+ years. Enrolment: 10.
Status: Ongoing, recruiting. Start date (EU): 2020-04-01. Decision date: 2024-07-10. Results received: No. Last updated: 2025-11-28.

Condition(s): glioblastoma multiforme, cancer
Product: Hyperpolarized [1-13C]pyruvate

Primary endpoint: [1-13C]pyruvate perfusion, uptake and conversion to [1-13C]lactate, [1-13C]alanine and [13C] bicarbonate in normal brain and tumor tissue
Endpoint(s): Perfusion (DCE MRI), Microvascular diffusion (ADC MRI), Amide proton transfer weight (APT) imaging, Progression-free survival (PFS), Overall survival (OS), Radiation dose distribution

Source: https://euclinicaltrials.eu/ctis-public/view/2024-515408-37-00